EU clinical trial 2024-519787-40-00: A Phase III, Multicentre, Randomised Controlled Study of Sonesitatug vedotin in Combination with Capecitabine with or without Rilvegostomig in First-line Claudin18.2-positive, HER2-negative, Advanced/Metastatic Gastric, Gastroesophageal Junction, or Esophageal Adenocarcinoma (CLARITY-Gastric 02)
Protocol code: D9803C00001
Sponsor: AstraZeneca AB (Pharmaceutical company). Phase: Therapeutic confirmatory (Phase III). Countries: France (ongoing, recruiting), Italy (authorised, recruiting), Spain (ongoing, recruiting), Hungary (ongoing, recruiting), Poland (ongoing, recruiting), Belgium (authorised, recruitment pending), Germany (authorised, recruitment pending), Netherlands (authorised, recruitment pending).
Therapeutic area(s): Diseases [C] - Neoplasms [C04]
Gender: Female, Male. Age: 18-64 years, 65+ years. Enrolment: 516.
Start date (EU): 2026-07-15. Decision date: 2026-06-16. Results received: No. Last updated: 2026-07-23.
Decision dates by country: FR: 2026-06-22, HU: 2026-06-16, IT: 2026-06-22, ES: 2026-06-17, NL: 2026-06-19, PL: 2026-06-18, BE: 2026-07-23, DE: 2026-07-13

Condition(s): Gastric Cancer, Gastroesophageal Junction Adenocarcinoma, Esophageal Cancer Expressing Claudin18.2
Product: BENDAFOLIN 10 mg/ml Injektionslösung, Vyloy 100 mg powder for concentrate for solution for infusion., Inflectra 100 mg powder for concentrate for solution for infusion, Mycofit, 250 mg, kapsułki twarde, OPDIVO 600 mg solution for injection, Capecitabine Accord 150 mg film-coated tablets, Oxaliplatin Bendalis 5 mg/ml Konzentrat zur Herstellung einer Infusionslösung, Rilvegostomig, Fluorouracil 50 mg/ml Solution for Injection or Infusion, AZD0901

Primary endpoint: Progression Free Survival (PFS) per RECIST 1.1 (Cohort 1 and Cohort 2), Overall Survival (OS) (Cohort 1 )
Endpoint(s): Overall Survival (OS) (Cohort 2), Overall Survival (OS) (Cohort 1 Arm B and C), Progression Free Survival (PFS) per RECIST 1.1 (Cohort 1 Arm B and C), Objective Response Rate (ORR) per RECIST 1.1 (Cohort 1 and Cohort 2), Duration of Response (DoR) per RECIST 1.1 (Cohort 1 and Cohort 2), Concentration of sonesitatug vedotin, total antibody and MMAE in serum and PK parameters (Cohort 1 and Cohort 2), Concentration of rilvegostomig in serum and PK parameters (Cohort 1), Presence of ADAs for sonesitatug vedotin (Cohort 1 and Cohort 2), Presence of ADAs for rilvegostomig (Cohort 1), Incidence of AEs and SAEs, changes from baseline in vital signs, clinical laboratory results, and ECGs (Cohort 1 and Cohort 2)

Source: https://euclinicaltrials.eu/ctis-public/view/2024-519787-40-00